EU clinical trial 2024-511950-35-00: BIOmarker driven intensification of cardiovascular RISK factor management in patients with high risk for recurrent cardiovascular EVENTs
Protocol code: FIMM-2024-02
Sponsor: Medical University Of Graz (Educational Institution). Phase: Therapeutic confirmatory (Phase III). Countries: Germany (ongoing, recruiting), Poland (ongoing, recruiting), Austria (ongoing, recruiting).
Therapeutic area(s): Diseases [C] - Cardiovascular Diseases [C14]
Gender: Female, Male. Age: 18-64 years, 65+ years. Enrolment: 1758.
Status: Ongoing, recruiting. Start date (EU): 2025-06-12. Decision date: 2025-05-14. Results received: No. Last updated: 2026-07-08.
Decision dates by country: DE: 2025-05-15, PL: 2025-05-19, AT: 2025-05-14

Condition(s): Acute Myocardial Infarction
Product: Vazkepa 998 mg soft capsules, COLCHICINE, EMPAGLIFLOZIN

Primary endpoint: Time to first event of a composite of cardiovascular outcomes encompassing - Cardiovascular death - Non-fatal myocardial infarction -Non-fatal stroke - Hospitalisation for urgent coronary revascularisation - Hospitalisation for heart failure
Endpoint(s): Time to first event for cardiovascular death, Time to all-cause mortality, Time to first event for non-fatal myocardial infarction, Time to first event for non-fatal stroke, Time to first event for hospitalisation for urgent coronary revascularisation, Time to first event for hospitalisation for heart failure, Time to first event of a composite of cardiovascular outcomes encompassing -Cardiovascular death -Non-fatal myocardial infarction -Non-fatal stroke, Time to first event of a composite of cardiovascular outcomes encompassing -Cardiovascular death -Hospitalisation for heart failure, Time to first event for any urgent revascularisation procedure of a -Coronary artery -Carotid artery -Peripheral artery, Time to first event for major adverse limb events

Source: https://euclinicaltrials.eu/ctis-public/view/2024-511950-35-00